EU clinical trial 2024-518783-13-00: Indocyanine green to assess vascularity of ileal conduit anastomosis and regulate ureteral resection margins during pelvic exenteration for recurrent/persistent gynecological cancer. A pilot study
Protocol code: GREEN-EX
Sponsor: Fondazione Policlinico Universitario Agostino Gemelli IRCCS (Hospital/Clinic/Other health care facility). Phase: Therapeutic exploratory (Phase II). Countries: Italy (ongoing, recruiting).
Therapeutic area(s): Diseases [C] - Neoplasms [C04]
Gender: Female. Age: 18-64 years, 65+ years. Enrolment: 40.
Status: Ongoing, recruiting. Start date (EU): 2023-11-09. Decision date: 2024-11-25. Results received: No. Last updated: 2024-11-25.

Condition(s): Patients with gynecological cancers undergoing pelvic exenteration
Product: INDOCYANINE GREEN

Primary endpoint: the overall rate of benign uretero-enteric stricture
Endpoint(s): Rate of Clavien Dindo grade three and four post-operative complications, both early (within 30 days after surgery) and late (from day 31 to day 180 after surgery), To assess the overall rate of ureteric leak in the study sample, To assess the differences in eGFR (i.e., renal function) over time (baseline, 1, 3 and 6 months) according to fluorescence levels, To assess 12-months overall survival (OS) and progression free survival (PFS)

Source: https://euclinicaltrials.eu/ctis-public/view/2024-518783-13-00